EU clinical trial 2023-504812-13-00: Effects of single-pill combination of telmisartan/amlodipine and telmisartan/amlodipine/hydrochlorothiazide on 24-hour blood pressure (BP) reduction, 24-h BP variability and office BP control in patients with arterial hypertension – SATELLITE
Protocol code: KCT02/2023-SATELLITE
Sponsor: KRKA tovarna zdravil d.d. Novo mesto (Pharmaceutical company). Phase: Phase III and phase IV (Integrated). Countries: Slovenia (ended), Hungary (ended), Poland (ended).
Therapeutic area(s): Diseases [C] - Cardiovascular Diseases [C14]
Gender: Female, Male. Age: 18-64 years, 65+ years. Enrolment: 110.
Status: Ended. Start date (EU): 2024-05-06. End date (EU): 2025-08-23. End date: 2025-08-24. Decision date: 2024-01-16. Results received: Yes. Last updated: 2025-08-22.
Decision dates by country: HU: 2024-01-22, SI: 2024-01-16, PL: 2024-01-19

Condition(s): Arterial hypertension
Product: Telmisartan/Amlodipine/Hydrochlorothiazide, Teldipin, 80 mg + 5 mg, tabletki, Telmisartan/Amlodipine/Hydrochlorothiazide, Tamloset 40 mg/5 mg tabletta, Tamloset 80 mg/10 mg tabletta, Telassmo 80 mg/10 mg tablete, Tamloset 80 mg/5 mg tabletta, Teldipin, 80 mg + 10 mg, tabletki, Telassmo 40 mg/5 mg tablete, Telmisartan/Amlodipine/Hydrochlorothiazide, Teldipin, 40 mg + 5 mg, tabletki, Telassmo 80 mg/5 mg tablete

Primary endpoint: Mean absolute change of 24-hour SBP after 16 weeks of treatment (from baseline to Visit 7) with TIMP.
Endpoint(s): Mean change in average real variability of 24-hour SBP (ARVs) and mean change in average real variability of 24-hour DBP (ARVd) after 16 weeks of treatment (from baseline to Visit 7) with TIMP., Mean absolute change of 24-hour DBP after 16 weeks of treatment (from baseline to Visit 7) with TIMP., Mean absolute and relative changes of office SBP and DBP after 4, 8, 12 and 16 weeks of treatment (from baseline to Visit 3, Visit 4, Visit 5 and Visit 7, respectively) with TIMP., Mean absolute change of the calculated central SBP (cSBP) and calculated central DBP (cDBP) after 16 weeks of treatment (from baseline to Visit 7) with TIMP., Mean SI after 16 weeks of treatment (from baseline to Visit 7) with TIMP., Mean absolute changes of 24-hour SBP, separately in groups of dipping, extreme dipping and non-dipping patients after 16 weeks of treatment (from baseline to Visit 7) with TIMP., Mean absolute change of pulse wave velocity (PWV) after 16 weeks of treatment (from baseline to Visit 7) with TIMP.

Source: https://euclinicaltrials.eu/ctis-public/view/2023-504812-13-00